EU clinical trial 2022-502559-69-01: A Phase II randomized, open label non-inferiority study of NiraParib maintenance after 3 vs. 6 cycles of platinum-based chemotherapy in completeLy debUlked advanced HRDpositive high-grade ovarian cancer patientS in first line therapy
Protocol code: NOGGO-ov53
Sponsor: Nord Ostdeutsche Gesellschaft Fuer Gynaekologische Onkologie e.V. (Laboratory/Research/Testing facility). Phase: Therapeutic exploratory (Phase II). Countries: Germany (ongoing, recruiting), Austria (ongoing, recruiting), Spain (ongoing, recruiting), Czechia (ongoing, recruiting), Belgium (ongoing, recruiting), Italy (ongoing, recruiting).
Therapeutic area(s): Diseases [C] - Neoplasms [C04]
Gender: Female. Age: 18-64 years, 65+ years. Enrolment: 640.
Status: Ongoing, recruiting. Start date (EU): 2024-07-04. Decision date: 2024-03-01. Results received: No. Last updated: 2026-02-16.
Decision dates by country: IT: 2025-01-29, AT: 2024-03-25, CZ: 2024-11-06, ES: 2024-11-20, BE: 2024-12-12, DE: 2024-03-01

Condition(s): advanced (FIGO stage IIIA, IIIB, IIIC, or IV of the 2014 FIGO classification) HRDpositive high-grade ovarian cancer, fallopian tube cancer, primary peritoneal cancer and clear cell carcinoma of the ovary with no residual tumor mass following primary tumor debulking
Product: PACLITAXEL, CARBOPLATIN, NIRAPARIB TOSILATE MONOHYDRATE, PACLITAXEL, CARBOPLATIN

Primary endpoint: RFS (Recurrence free survival, defined as time from treatment randomization to the earliest date of assessment of first relapse or death by any cause)
Endpoint(s): Overall survival (OS) (time to event and rate at 3 and 5 years), Time to first subsequent treatment (TFST), TWIST (Time Without Symptoms of disease progression or Toxicity of treatment) at baseline, 3, 6, and 12 months, PFS2 (Time from randomization until the date of second objective disease progression or death by any cause), PROs (EORTC QLQ-C30 and EORTC QLQ-OV28), Safety assessment includes AEs/SAEs, laboratory evaluations, vital signs and physical examination, Cost effectiveness

Source: https://euclinicaltrials.eu/ctis-public/view/2022-502559-69-01